EU clinical trial 2022-502137-26-00: A Trial to Study if REGN5837 in Combination with Odronextamab is Safe for Adult Participants with Aggressive B-cell Non-Hodgkin Lymphomas
Protocol code: R5837-ONC-2019
Sponsor: Regeneron Pharmaceuticals Inc. (Pharmaceutical company). Phase: Human Pharmacology (Phase I)- First administration to humans. Countries: Spain (ongoing, recruitment ended), Netherlands (ongoing, recruitment ended), France (ongoing, recruitment ended).
Therapeutic area(s): Diseases [C] - Hemic and Lymphatic Diseases [C15]
Gender: Female, Male. Age: 18-64 years, 65+ years. Enrolment: 42.
Status: Ongoing, recruitment ended. Start date (EU): 2026-08-05. Decision date: 2023-08-23. Results received: No. Last updated: 2026-08-03.
Decision dates by country: NL: 2023-08-25, ES: 2023-08-23, FR: 2023-08-25

Condition(s): B-cell Non-Hodgkins Lymphoma (B-NHL)

Source: https://euclinicaltrials.eu/ctis-public/view/2022-502137-26-00